EU clinical trial 2024-516727-13-00: Imlifidase in ANCA-associated Vasculitis
Protocol code: ImlifidARDSe.01
Sponsor: Charite Universitaetsmedizin Berlin KöR (Hospital/Clinic/Other health care facility). Phase: Therapeutic exploratory (Phase II). Countries: Germany (ongoing, recruitment ended).
Therapeutic area(s): Diseases [C] - Immune System Diseases [C20]
Gender: Female, Male. Age: 18-64 years, 65+ years. Enrolment: 10.
Status: Ongoing, recruitment ended. Start date (EU): 2023-05-17. Decision date: 2024-10-21. Results received: No. Last updated: 2026-05-07.

Condition(s): Anti-neutrophil cytoplasmic antibody (ANCA) associated vasculitis with severe diffuse alveolar hemorrhage
Product: Idefirix 11 mg powder for concentrate for solution for infusion

Primary endpoint: ANCA seroconversion (indicated by titerbelow reference range) within 24 hours of imlifidase administration
Endpoint(s): Time to ANCA seroconversion (indicated by ELISA below reference range), Rebound of ANCA serology greater than 50% of the initial fall in titer (i.e. rise > (ANCAmax – ANCAmin) / 2), Mortality (30 days), Duration of ICU stay, Amelioration of lung function o Duration of invasive ventilation / ECMO o Time to resolution of ARDS (measured by Horowitz Index), Amelioration of kidney function o Upstaging of Kidney Disease: Improving Global Outcomes (KDIGO) Acute Kidney Injury (AKI) stages o Kidney replacement therapy-dependency at 3 and 6 months after inclusion, Safety Endpoint: Frequency and distribution of safety parameters (adverse events (AEs), severe adverse events (SAEs), clinical laboratory tests, vital signs), Safety Endpoint: Frequency and quality of infectious complications

Source: https://euclinicaltrials.eu/ctis-public/view/2024-516727-13-00